EU clinical trial 2023-508932-68-00: A Double-blind, Randomized, Placebo-controlled, 4-arm Parallel-group, Multiple-Dose Study to Assess Efficacy and Safety of Medical Cannabis Aerosol via the Fixed-dose Syqe Inhaler as an Add-on Treatment of Diabetic Peripheral Neuropathic Pain
Protocol code: Syqe-004
Sponsor: Syqe Medical Ltd. (Pharmaceutical company). Phase: Therapeutic exploratory (Phase II). Countries: Poland (ended), Czechia (ended), Germany (ended).
Therapeutic area(s): Diseases [C] - Nervous System Diseases [C10]
Gender: Female, Male. Age: 18-64 years, 65+ years. Enrolment: 137.
Status: Ended. Start date (EU): 2024-11-14. End date (EU): 2026-06-24. End date: 2026-06-25. Decision date: 2024-07-19. Results received: No. Last updated: 2026-03-16.
Decision dates by country: DE: 2024-08-06, CZ: 2024-07-24, PL: 2024-07-19

Condition(s): Diabetic Peripheral Neuropathic Pain
Product: The placebo (SQE-001-PB) will provide the sensation of an inhalation and inhaler operation without any detectable cannabinoid components emitted., Cannabis Sativa L. ‘Afina’ inflorescence aerosol via the Syqe Inhaler (drug-device combination)

Primary endpoint: 1. Change from baseline in weekly-mean 24-hour average pain score (using the 11-point Numeric Rating Scale [NRS]) at Week 16.
Endpoint(s): 1. Change from baseline in Neuropathic Pain Symptom Inventory and in Brief Pain Inventory – Short Form., 2. Change from baseline in weekly-mean 24-hour average, worst and least pain score (using the 11-point NRS)., 3. Proportion of patients achieving at least 30% and 50% reduction from baseline in the weekly-mean 24-hour average pain score (using the 11-point NRS)., 4. Proportion of patients with treatment-emergent adverse events (TEAEs) and their severity, AEs leading to study treatment discontinuation, TEAEs of special interest, and serious TEAEs., 5. Safety and tolerability will also be assessed by Michigan Neuropathy Screening Instrument Part B, Columbia-Suicide Severity Rating Scale, spirometry, electrocardiogram, laboratory blood, and urine tests., 6. Pharmacokinetic concentrations and parameters (pre-dose plasma concentration [Ctrough], maximum observed steady state concentration [Cmax ss], time at which maximum observed steady state concentration occurs [Tmax ss], area under the concentration-time curve [AUC]) of Δ9-THC, cannabidiol, cannabinol, 11-OH-THC, and 11-COOH-THC at selected visits., 7. Proportion of patients who need rescue medication for the treatment of DPNP., 8. Frequency and amount of rescue medication taken and time to first intake for the treatment of DPNP., 9. Change from baseline in weekly-mean 24-hour sleep score using the 11-point Daily Sleep Interference Scale and the Pain and Sleep Questionnaire-3., 10. Change from baseline in Patient-Reported Outcomes Measurement Information System-29 Profile v2.1 total score.

Source: https://euclinicaltrials.eu/ctis-public/view/2023-508932-68-00